EU clinical trial 2023-506862-30-00: LAMAinDiab - lisdexamphetamine vs methylphenidate for pediatric patients with ADHD and type 1 diabetes - a randomized crossover clinical trial.
Protocol code: LAMA/2021/1
Sponsor: Medical University Of Lodz (Educational Institution). Phase: Therapeutic exploratory (Phase II). Countries: Poland (ongoing, recruiting).
Therapeutic area(s): Diseases [C] - Nutritional and Metabolic Diseases [C18]; Psychiatry and Psychology [F] - Behavior and Behavior Mechanisms [F01]
Gender: Female, Male. Age: 0-17 years. Enrolment: 150.
Status: Ongoing, recruiting. Start date (EU): 2024-11-24. Decision date: 2024-11-24. Results received: No. Last updated: 2026-06-15.

Condition(s): Attention-deficit hyperactivity disorder, Type 1 diabetes
Product: Concerta, 18 mg, tabletki o przedłużonym uwalnianiu, Elvanse, 30 mg, kapsułki, twarde, Elvanse, 50 mg, kapsułki, twarde, Concerta 54 mg, tabletten met verlengde afgifte., Elvanse, 70 mg, kapsułki, twarde, Concerta, 36 mg, tabletki o przedłużonym uwalnianiu

Primary endpoint: The difference in ADHD symptom scores on the scale of "inattention" of the Conners 3 questionnaire between the measurement before pharmacotherapy (after completion of PTBM) and the measurement at the end of the 6-month course of pharmacotherapy with LDX or MPH; and a similar difference (between the value measured before pharmacotherapy and after 6 months of therapy) for the other drug (endpoint assessment by the investigator blinded to patient allocation)., The difference in ADHD symptom scores on the hyperactivity/impulsivity scale of the Conners 3 questionnaire between the pre-drug (post-PTBM) and post-drug (6-month LDX or MPH) measures; and the corresponding difference (between the pre-drug and 6-month measures) for the second drug (endpoint assessed by an investigator blinded to patient allocation)., The number and frequency of adverse events described by the MedDRA dictionary reported in both cycles of pharmacotherapy.
Endpoint(s): Difference in HbA1c measured at the end of MPH pharmacotherapy cycle and LDX relative to the measurement before pharmacotherapy was started., Difference in percentage of time spent by child for 14 days at the end of the MPH and LDX pharmacotherapy cycle relative to the 14 days preceding the initiation of pharmacotherapy in the following CGM measurement glycemic ranges: - target (70-180mg/dl), - hypoglycemia (<70mg/dl), - clinically significant hypoglycemia (<54mg/dl), - hyperglycemia (>180mg/dl), - significant hyperglycemia (>250mg/dl)., Difference in the mean glycemia and in the coefficient of variation of the of glycemia calculated as the ratio of the standard deviation of the of glycemia to mean glycemia (expressed as a percentage) calculated for the 14 days at the end of the MPH and LDX pharmacotherapy cycle vs.14 days prior to the start of pharmacotherapy 14 days prior to pharmacotherapy initiation., Difference between declared quality of life and quality of life with diabetes of the study participant after each cycle of pharmacotherapy (LDX or MPH) relative to the quality of life assessed at the time point after completion of PTBM, preceding the initiation of pharmacotherapy., Difference between the declared quality of life and the quality of life with diabetes of the study participant after each cycle of pharmacotherapy (LDX or MPH) relative to the quality of life assessed at the time point after completion of PTBM, preceding initiation of pharmacotherapy.

Source: https://euclinicaltrials.eu/ctis-public/view/2023-506862-30-00